EU clinical trial 2023-506029-12-00: Randomized, Double-Blind, Placebo-Controlled, Multiple-Attack Study with an Open-Label Extension to Evaluate the Efficacy, Safety, Tolerability, and the Consistency of Effect of Atogepant for the Acute Treatment of Migraine (ECLIPSE)
Protocol code: M24-305
Sponsor: AbbVie Deutschland GmbH & Co. KG (Pharmaceutical company). Phase: Therapeutic confirmatory (Phase III). Countries: Spain (ended), Germany (ended), Poland (ongoing, recruitment ended), Czechia (ongoing, recruitment ended), Belgium (ended), Slovakia (ended), Hungary (ended), Italy (ended), Sweden (ended), Portugal (ended).
Therapeutic area(s): Diseases [C] - Nervous System Diseases [C10]
Gender: Female, Male. Age: 18-64 years, 65+ years. Enrolment: 1013.
Start date (EU): 2024-04-03. Decision date: 2024-03-20. Results received: No. Last updated: 2026-07-06.
Decision dates by country: BE: 2024-03-25, HU: 2024-06-17, PL: 2024-04-02, IT: 2024-03-27, SE: 2024-03-25, CZ: 2024-03-27, DE: 2024-03-22, SK: 2024-03-21, ES: 2024-03-20, PT: 2024-03-22

Condition(s): Migraine
Product: Placebo for atogepant tablets 60mg, Atogepant

Primary endpoint: Pain freedom (defined as a reduction in headache severity from moderate/severe at baseline [predose] to no pain) at 2 hours after the DB dose for the first attack
Endpoint(s): Absence of the MBS at 2 hours after the DB dose for the first attack (coprimary endpoint for China), Pain relief (defined as the reduction of a moderate/severe migraine headache at baseline [predose] to a mild headache or to no headache) at 2 hours after the DB dose for the first attack, Sustained pain relief from 2 to 24 hours (defined as pain relief at 2 hours after the DB dose with no administration of rescue medication and no occurrence of a moderate/severe headache from 2 to 24 hours) after the DB dose for the first attack, Sustained pain relief from 2 to 48 hours after the DB dose for the first attack, Use of rescue medication within 24 hours after the DB dose for the first attack, Ability to function normally at 2 hours after the DB dose for the first attack, Sustained pain freedom from 2 to 24 hours (defined as pain freedom at 2 hours after the DB dose with no administration of rescue medication and no occurrence of a mild/moderate/severe headache from 2 to 24 hours) after the DB dose for the first attack, Sustained pain freedom from 2 to 48 hours after the DB dose for the first attack, Absence of photophobia at 2 hours after the DB dose for the first attack, Absence of phonophobia at 2 hours after the DB dose for the first attack, Pain freedom at 8 hours after the DB dose for the first attack, Ability to function normally 8 hours after the DB dose for the first attack, Pain relief at 1 hour after the DB dose for the first attack, Absence of nausea at 2 hours after the DB dose for the first attack, Pain relief at 30 minutes after the DB dose for the first attack, Ability to function normally at 1 hour after the DB dose for the first attack

Source: https://euclinicaltrials.eu/ctis-public/view/2023-506029-12-00